EU clinical trial 2025-523898-42-00: The SURF trial: Optimizing Surgical excision Using Real-time Fluorescence imaging with indocyanine green
Sponsor: Erasmus Universitair Medisch Centrum Rotterdam (Erasmus MC) (Hospital/Clinic/Other health care facility). Phase: Phase II and Phase III (Integrated). Countries: Netherlands (authorised, recruitment pending).
Therapeutic area(s): Diseases [C] - Neoplasms [C04]
Gender: Female, Male. Age: 18-64 years, 65+ years. Enrolment: 40.
Status: Authorised, recruitment pending. Decision date: 2026-01-13. Results received: No. Last updated: 2026-04-28.

Condition(s): Histologically confirmed solid malignancy (e.g., head and neck, gastrointestinal, hepatobiliary, breast, genitourinary, sarcoma)
Product: VERDYE 5 mg/ml poeder voor oplossing voor injectie

Primary endpoint: Tumor-to-background ratio (TBR) ≥ 1.5 on ex vivo imaging of resected specimens., Proportion of patients with histologically confirmed clear surgical margins (≥1 mm) in fluorescent vs. non-fluorescent areas
Endpoint(s): Concordance between fluorescence signal and histopathology at wound bed and specimen, Number of additional fluorescent lesions biopsied and confirmed as tumor, as well as the number of false-positive and false-negative lesions, Mean fluorescence intensity (MFI) in metastatic vs. non-metastatic lymph nodes, Incidence and severity of adverse events (AEs) and serious adverse events (SAEs), Concordance of ICG fluorescence with complementary imaging or spectroscopy signals, clinical findings, and histopathological outcomes.

Source: https://euclinicaltrials.eu/ctis-public/view/2025-523898-42-00